EU clinical trial 2023-504340-34-01: Drug-Coated Balloon in Anticoagulated and Bleeding Risk Patients Undergoing PCI (DEBATE)
Sponsor: Wellbeing Services County Of North Karelia Siun Sote (Hospital/Clinic/Other health care facility). Phase: Therapeutic use (Phase IV). Countries: Finland (ongoing, recruiting), France (ongoing, recruiting), Spain (ongoing, recruiting).
Therapeutic area(s): Diseases [C] - Cardiovascular Diseases [C14]
Gender: Female, Male. Age: 18-64 years, 65+ years. Enrolment: 734.
Status: Ongoing, recruiting. Start date (EU): 2024-01-11. Decision date: 2024-01-11. Results received: No. Last updated: 2025-06-26.
Decision dates by country: FI: 2024-01-11, FR: 2024-10-21, ES: 2025-06-26

Condition(s): Coronary artery disease
Product: ASPIRIN CARDIO 100 mg comprimate gastrorezistente, Efient 10 mg film-coated tablets., Brilique 90 mg film-coated tablets, Plavix 75 mg film-coated tablets

Primary endpoint: The primary endpoint is the composite of MACE and BARC (Bleeding academic research consortium) type 2-5 bleeding episodes at 12 months. Major Adverse Cardiac Event = a composite of cardiac death, nonfatal myocardial infarction (MI) and ischemia driven-target lesion revascularization (ID-TLR)
Endpoint(s): The composite of MACE and BARC2-5 bleedings (24 and 36 months), MACE 12, 24 and 26 months, BARC2-5 bleedings 12, 24 and 26 months, BARC3-5 bleedings 12, 24 and 26 months, Total mortality 12, 24 and 26 months, Cardiovascular mortality 12, 24 and 26 months, Myocardial infarction 12, 24 and 26 months, TLR 12, 24 and 26 months, Target-vessel failure (TVF) 12, 24 and 26 months, Target-lesion failure (TLF) 12, 24 and 26 months, The composite of TLR and BARC2-5 bleedings 12, 24 and 26 months, The composite of TVF and BARC2-5 bleedings 12, 24 and 26 months, The composite of TLF and BARC2-5 bleedings 12, 24 and 26 months, The composite of TLR and BARC3-5 bleedings 12, 24 and 26 months, Acute vessel closure as defined by the consensus criteria for definite/probable stent thrombosis, Hospitalization for urgent revascularization, Stroke (ischemic or hemorrhagic) or TIA 12, 24 and 26 months

Source: https://euclinicaltrials.eu/ctis-public/view/2023-504340-34-01